EU clinical trial 2024-514560-10-00: Systemic antitumor treatment with or without pressurized intraperitoneal aerosol chemotherapy (PIPAC) for colon peritoneal metastases – a multicentre phase II randomized trial (PIPOX02)
Protocol code: ICO-2023-14
Sponsor: Institut De Cancerologie De L Ouest (Hospital/Clinic/Other health care facility). Phase: Therapeutic exploratory (Phase II). Countries: France (ongoing, recruiting).
Therapeutic area(s): Diseases [C] - Neoplasms [C04]
Gender: Female, Male. Age: 18-64 years, 65+ years. Enrolment: 114.
Status: Ongoing, recruiting. Start date (EU): 2025-06-12. Decision date: 2024-10-11. Results received: No. Last updated: 2026-03-16.

Condition(s): Patients with newly diagnosed advanced peritoneal metastasis from colon and colorectal junction cancer
Product: Abevmy 25 mg/mL concentrate for solution for infusion., CAPECITABINE VIATRIS 150 mg, comprimé pelliculé, IRINOTECAN VIATRIS 20 mg/ml, solution à diluer pour perfusion, OXALIPLATINE ARROW LAB 5 mg/mL, solution à diluer pour perfusion, Fluorouracil 25 mg/ml Solution for Injection or Infusion, Erbitux 5 mg/mL solution for infusion, Vectibix 20 mg/ml concentrate for solution for infusion

Primary endpoint: Progression free survival (PFS) is defined as the time (in months) from randomisation until the date of progression or death from any cause.
Endpoint(s): a) Overall survival (OS) defined as the time relapsed between randomisation and death from any cause, b) EORTC QLQ-C30 (Appendix 12) and the EORTC QLQ-CR29 (Appendix 13) questionnaires, c) • Toxicities ≥ grade 3 related to chemotherapy (IV, PO or PIPAC), targeted therapy and abdominal surgery (laparoscopy, PIPAC procedure, biopsies, CRS) assessed according to the Common Terminology Criteria for Adverse Events (CTCAE), version 5.0 (Appendix 10); • Toxicities ≥ grade 3 related to abdominal surgery as assessed by the CLAVIEN DINDO score (Appendix 11). • Toxicities of any grade about peripheral neuropathy assessed according to the Common Terminology Criteria for Adverse Events (CTC, d) Resection rate defined as proportion of patients who proceed to secondary cytoreductive surgery CC0 or CC1 with or without hyperthermic intraperitoneal chemotherapy (HIPEC), e) Peritoneal progression free survival defined as the time between the date of randomisation and the date of peritoneal progression or death from any cause., f) OFS is defined as the time between the date of randomisation and the appearance of gastrointestinal obstruction requiring medication with high dose of corticosteroïd (> 1mg/kg) or intervention as nasogastric decompression, intraluminal stenting, surgical bypass, or decompression stomy (gastrostomy or ileo/colostomy) or death., g) Peritoneal regression grading score (PRGS) (Appendix 6) on biopsies performed at surgical exploration in both groups, and systematically during 1st and 2nd PIPAC procedure., h) PCI < 20 and PCI ≥ 20, i) PFS benefit of adding PIPAC to systemic chemotherapy after baseline PCI: PCI < 20 and PCI ≥ 20, j) PFS according to PRGS (1-2 vs 3-4) after the 2nd PIPAC, k) PFS following tumor mutation status (KRAS wt vs KRAS mt and BRAF wt vs BRAF mt)

Source: https://euclinicaltrials.eu/ctis-public/view/2024-514560-10-00